EU clinical trial 2024-515312-50-00: Investigating the (autoreactive) B cell compartment in antibody-mediated autoimmune diseases in comparison with the recall Tetanus Toxoid response
Sponsor: Leids Universitair Medisch Centrum (LUMC) (Hospital/Clinic/Other health care facility). Phase: Therapeutic use (Phase IV). Countries: Netherlands (authorised, recruitment pending).
Therapeutic area(s): Diseases [C] - Musculoskeletal Diseases [C05]
Gender: Female, Male. Age: 18-64 years, 65+ years. Enrolment: 96.
Status: Authorised, recruitment pending. Decision date: 2025-07-08. Results received: No. Last updated: 2025-07-08.

Condition(s): Systemic sclerosis, Systemic lupus erythematosus, Rheumatoid arthritis
Product: Tetanusvaccin, suspensie voor injectie 40 IE

Primary endpoint: the frequency and phenotype of antigen-specific, autoreactive B cells in the peripheral blood of patients at the indicated time-points, compared to the frequency and phenotype of TT-specific B cells prior to and upon booster vaccination, at the same timepoints. Assessment will be done by flow cytometry, generating a phenotypic profile rather than a single parameter.
Endpoint(s): plasma levels and characteristics (e.g. glycosylation) of autoantibodies and anti-TT antibodies during different stages of activation of the underlying B cell responses., phenotype and dynamics of TT-specific B cells before and upon vaccination in healthy individuals.

Source: https://euclinicaltrials.eu/ctis-public/view/2024-515312-50-00